EU clinical trial 2025-523134-28-00: A national randomised multi-centre phase II/III trial using MesoPher in ABC borderline resectable pancreatic cancer (PREOPANC-6 trial)
Protocol code: 14395
Sponsor: Erasmus Universitair Medisch Centrum Rotterdam (Erasmus MC) (Hospital/Clinic/Other health care facility). Phase: Phase II and Phase III (Integrated). Countries: Netherlands (authorised, recruitment pending).
Therapeutic area(s): Diseases [C] - Neoplasms [C04]; Analytical, Diagnostic and Therapeutic Techniques and Equipment [E] - Therapeutics [E02]
Gender: Female, Male. Age: 18-64 years, 65+ years. Enrolment: 143.
Status: Authorised, recruitment pending. Decision date: 2026-05-11. Results received: No. Last updated: 2026-05-11.

Condition(s): ABC borderline resectable pancreatic cancer

Primary endpoint: Phase II Progression-free survival (PFS): defined as the time from initiation of study treatment to the first documented recurrent disease or progressive disease (PD) per RECIST 1.1, or death to any cause, whichever occurs first (exploratory endpoint), Phase III Overall survival (OS): the time from inclusion to death due to any cause.
Endpoint(s): Phase II Assessments of immune responses • Vaccine-induced responses by analysing peripheral blood mononuclear cells (PBMCs) and performing NanoString analyses • Modulation of peripheral immune cell subsets by analysing PBMCs • Predictive gene expression signatures related to therapy outcome by using nCounter NanoString analyses, Phase II Disease-free survival: defined as the first documented evidence of recurrence of disease as defined by RECIST 1.1 criteria., Phase II Patient reported quality of life using the EORTC QLQC30 and the EORTC-QLQPAN26 questionnaires., Phase II To assess safety by AEs and study intervention discontinuations due to AEs., Phase III Assessments of immune responses • Vaccine-induced responses by analysing peripheral blood mononuclear cells (PBMCs) and performing NanoString analyses •Modulation of peripheral immune cell subsets by analysing PBMCs • Predictive gene expression signatures related to therapy outcome by using nCounter NanoString analyses, Phase III Disease-free survival: defined as the first documented evidence of recurrence of disease as defined by RECIST 1.1 criteria., Pase III Event-free survival: defined as the time from randomisation to any of the following events: failure to undergo surgery, disease recurrence, or death from any cause., Phase III Patient reported quality of life using the EORTC QLQC30 and the EORTC-QLQPAN26 questionnaires., Phase III To assess safety by AEs and study intervention discontinuations due to AEs., Phase III: Progression-free survival (PFS): defined as the time from initiation of study treatment to the first documented recurrent disease or progressive disease (PD) per RECIST 1.1, or death to any cause, whichever occurs first.

Source: https://euclinicaltrials.eu/ctis-public/view/2025-523134-28-00